EU clinical trial 2024-516870-31-00: A Phase 1 Open-label Study to Evaluate the Safety and Efficacy of MK‑8294 Monotherapy in Advanced Solid Tumors
Protocol code: MK-8294-001
Sponsor: Merck Sharp & Dohme LLC (Pharmaceutical company). Phase: Human Pharmacology (Phase I)- First administration to humans. Countries: Netherlands (ongoing, recruiting).
Therapeutic area(s): Diseases [C] - Neoplasms [C04]
Gender: Female, Male. Age: 18-64 years, 65+ years. Enrolment: 21.
Status: Ongoing, recruiting. Start date (EU): 2025-07-11. Decision date: 2025-04-11. Results received: No. Last updated: 2026-05-28.

Condition(s): Endometrial Carcinoma, Bladder Cancer, Head and neck squamous cell carcinoma, Esophageal squamous cell carcinoma, Cervical squamous cell carcinoma, Breast Cancer

Source: https://euclinicaltrials.eu/ctis-public/view/2024-516870-31-00